EU clinical trial 2024-514488-24-02: (CIAO@TBI) Complement Inhibition: Attacking Overshooting Inflammation @fter traumatic brain injury
Sponsor: Leids Universitair Medisch Centrum (LUMC) (Hospital/Clinic/Other health care facility). Phase: Therapeutic exploratory (Phase II). Countries: Netherlands (ongoing, recruitment ended).
Therapeutic area(s): Analytical, Diagnostic and Therapeutic Techniques and Equipment [E] - Therapeutics [E02]; Diseases [C] - Nervous System Diseases [C10]
Gender: Female, Male. Age: 18-64 years, 65+ years. Enrolment: 106.
Status: Ongoing, recruitment ended. Start date (EU): 2024-10-09. Decision date: 2024-10-08. Results received: No. Last updated: 2026-01-23.

Condition(s): Traumatic Brain Injury
Product: Cinryze 500 IU powder and solvent for solution for injection, Saline Solution Basi 9 mg/ml solution for infusion

Primary endpoint: Therapy Intensity Level Scale
Endpoint(s): Serious Adverse Events (SAE), Glasgow Outcome Scale Extended

Source: https://euclinicaltrials.eu/ctis-public/view/2024-514488-24-02